EU clinical trial 2024-515786-34-02: A Positron Emission Tomography (PET) study to examine the properties of a novel radioligand's suitability for imaging mutant huntingtin
Protocol code: CS-5583
Sponsor: CHDI Foundation Inc. (Patient organisation/association). Phase: Human Pharmacology (Phase I)- Other. Countries: Belgium (ongoing, recruiting).
Therapeutic area(s): Diseases [C] - Congenital, Hereditary, and Neonatal Diseases and Abnormalities [C16]
Gender: Female, Male. Age: 18-64 years. Enrolment: 27.
Status: Ongoing, recruiting. Start date (EU): 2026-02-24. Decision date: 2024-12-17. Results received: No. Last updated: 2026-04-02.

Condition(s): Huntington's disease

Source: https://euclinicaltrials.eu/ctis-public/view/2024-515786-34-02